EU clinical trial 2024-513312-95-00: An Open-Label, Dose Escalation and Dose Expansion Trial Evaluating the Safety, Pharmacokinetics, Pharmacodynamics, and Clinical Activity of Orally Administered CA-4948 in Patients With Relapsed or Refractory Primary Central Nervous System Lymphoma
Protocol code: CA-4948-101
Sponsor: Curis Inc. (Pharmaceutical company). Phase: Phase I and Phase II (Integrated)- First administration to humans. Countries: Poland (ongoing, recruiting), France (ongoing, recruiting), Spain (ongoing, recruiting), Czechia (ongoing, recruiting), Italy (ongoing, recruiting).
Therapeutic area(s): Diseases [C] - Neoplasms [C04]
Gender: Female, Male. Age: 18-64 years, 65+ years. Enrolment: 69.
Status: Ongoing, recruiting. Start date (EU): 2023-05-30. Decision date: 2024-07-01. Results received: No. Last updated: 2026-06-23.
Decision dates by country: FR: 2024-07-08, IT: 2024-07-08, PL: 2024-07-17, CZ: 2024-07-03, ES: 2024-07-01

Condition(s): Part B+C. Primary central nervous system lymphoma (PCNSL), Part A2. Relapsed or Refractory Hematologic Malignancy. (Enrolment is closed)
Product: IBRUTINIB, CA-4948

Primary endpoint: Part A1 and Part A2: •Incidence of DLTs •Incidence of adverse events (AEs) •Clinically significant changes in vital signs and laboratory parameters • Clinically significant changes from baseline in electrocardiograms (ECGs), Part B: ORR: the percentage of patients achieving CR, unconfirmed complete response (CRu), or PR (as determined by an independent review committee [IRC] assessment for Cohort 2 only) using the International Primary CNS Lymphoma Collaborative Group (IPCG) Response Criteria guidelines for PCNSL (Abrey et al, 2005), Part C: ORR: the percentage of patients achieving CR, CRu, or PR using the IPCG Response Criteria guidelines for PCNSL (Abrey et al, 2005)
Endpoint(s): Part A1 and Part A2: • Maximum observed plasma concentration (Cmax) • Minimum observed plasma concentration (Cmin) • Time after dosing that a drug is present at the maximum concentration in serum (Tmax) • Area under the concentration-time curve (AUC) • Terminal elimination half-life (T1/2), Part A1 and Part A2: • ORR: complete response (CR) + partial response (PR) • Waldenström macroglobulinemia/ lymphoplasmacytic lymphoma (WM/LPL) ORR: CR + PR + very good partial response (VGPR), Part A1 and Part A2: • DOR: time from CR or PR to first documentation of relapse, disease progression, or death from any cause • WM/LPL DOR: time from CR, PR, or VGPR to first documentation of relapse, disease progression, or death from any cause, Part A1 and Part A2: • DCR: PR + CR + stable disease • WM/LPL DCR: CR + PR + VGPR + stable disease, Part A1 and Part A2: • PFS: time from date of first dose of study treatment until first documentation of relapse, disease progression, or death from any cause, Part A1 and Part A2: OS: time from date of first dose of study treatment until death from any cause, Part B+C: DOR:the time from the date CR, CRu, or PR is achieved to the date of first documented disease progression (as determined by an IRC assessment for Cohort 2 only) or death due to any cause, whichever occurs first/PFS:the time from the date of the first dose of study treatment to the date of the first documented disease progression (as determined by an IRC assessment for Cohort 2 only) or death due to any cause, whichever occurs first/OS:the time from date of 1st dose until death, Part B+C: Incidence of treatment-emergent adverse events (TEAEs) and treatment-related AEs, physical examinations, vital signs, ECGs, and laboratory values, Part B+C: PK parameters including but not limited to AUC, Cmax, Tmax, and T1/2 for emavusertib and ibrutinib

Source: https://euclinicaltrials.eu/ctis-public/view/2024-513312-95-00